EU clinical trial 2023-505042-25-00: A Phase III Double-blind Randomised Study Assessing the Efficacy and Safety of Capivasertib + Fulvestrant Versus Placebo + Fulvestrant as Treatment for Locally Advanced (Inoperable) or Metastatic Hormone Receptor Positive, Human Epidermal Growth Factor Receptor 2 Negative (HR+/HER2−) Breast Cancer Following Recurrence or Progression On or After Treatment with an Aromatase Inhibitor (CAPItello-291)
Protocol code: D3615C00001
Sponsor: AstraZeneca AB (Pharmaceutical company). Phase: Therapeutic confirmatory (Phase III). Countries: Poland (ended), Spain (ended), France (ended), Italy (ongoing, recruitment ended), Belgium (ended), Germany (ended), Hungary (ended).
Therapeutic area(s): Diseases [C] - Neoplasms [C04]
Gender: Female, Male. Age: 18-64 years, 65+ years. Enrolment: 366.
Start date (EU): 2020-05-05. Decision date: 2024-02-14. Results received: No. Last updated: 2025-11-25.
Decision dates by country: HU: 2024-02-15, DE: 2024-02-19, FR: 2024-02-16, BE: 2024-02-19, PL: 2024-02-16, ES: 2024-04-24, IT: 2024-02-19

Condition(s): Locally advanced (inoperable) or metastatic HR+/HER2 breast cancer
Product: Capivasertib, Faslodex 250 mg solution for injection., Placebo to Capivasertib, Capivasertib

Primary endpoint: Progression-free survival (PFS) is defined as the time from randomisation until progression per RECIST v1.1, as assessed by the investigator at the local site, or death due to any cause.
Endpoint(s): OS, overall survival, PFS2, time from randomisation to second progression or death., ORR, objective response rate., DoR, duration of response., CBR, clinical benefit rate., Safety and tolerability evaluated as AEs/SAEs, vital signs, clinical chemistry/haematology/glucose metabolism parameters, and ECG parameters., Plasma concentration of capivasertib., EORTC QLQ-C30, EORTC Quality of Life Questionnaire-Core 30 items and EORTC QLQ-BR23, EORTC Quality of Life Questionnaire breast cancer specific module,scale/item scores., Deterioration of ECOG, Eastern Cooperative Oncology Group, performance status.

Source: https://euclinicaltrials.eu/ctis-public/view/2023-505042-25-00